EU clinical trial 2022-500660-35-00: A Study to Assess the Safety, Tolerability and Immunological Response of ASP2390 in Adult Subjects Allergic to House Dust Mites
Protocol code: 2390-CL-0001
Sponsor: Astellas Pharma Global Development Inc. (Pharmaceutical company). Phase: Human Pharmacology (Phase I)- First administration to humans. Countries: Germany (ongoing, recruitment ended).
Therapeutic area(s): Diseases [C] - Immune System Diseases [C20]
Gender: Female, Male. Age: 18-64 years, 65+ years. Enrolment: 28.
Status: Ongoing, recruitment ended. Start date (EU): 2020-02-17. Decision date: 2023-03-21. Results received: No. Last updated: 2025-11-19.

Condition(s): Allergy to House Dust Mites

Source: https://euclinicaltrials.eu/ctis-public/view/2022-500660-35-00